EU clinical trial 2023-508356-19-00: An Open-Label Multicenter 3-Arm Randomized Phase 2 Study to Assess the Efficacy and Safety of TTX-030 and Chemotherapy With or Without Budigalimab, Compared to Chemotherapy Alone, for the Treatment of Patients not Previously Treated for Metastatic Pancreatic Adenocarcinoma
Protocol code: TTX-030-003
Sponsor: Trishula Therapeutics Inc. (Pharmaceutical company). Phase: Therapeutic exploratory (Phase II). Countries: Spain (ended), France (ended), Italy (ended), Czechia (ended).
Therapeutic area(s): Diseases [C] - Neoplasms [C04]; Diseases [C] - Digestive System Diseases [C06]
Gender: Female, Male. Age: 18-64 years, 65+ years. Enrolment: 50.
Status: Ended. Start date (EU): 2024-06-25. End date (EU): 2026-02-17. End date: 2026-03-04. Decision date: 2024-05-27. Results received: Yes. Last updated: 2025-10-27.
Decision dates by country: CZ: 2024-05-29, IT: 2024-05-29, ES: 2024-05-27, FR: 2024-06-03

Condition(s): Pancreatic adenocarcinoma metastatic
Product: Budigalimab, PACLITAXEL, TTX-030, GEMCITABINE

Primary endpoint: Progression-free survival (PFS)
Endpoint(s): Progression-free survival, Objective response rate, Duration of response, Overall survival (PFS, ORR, DoR, OS), Type, severity, and frequency of treatment-emergent AEs

Source: https://euclinicaltrials.eu/ctis-public/view/2023-508356-19-00